EU clinical trial 2023-506965-72-00: An open-label, single-center study to evaluate the safety and test-retest characteristics of [11C]MODAG-005 as PET radioligand for imaging pathological alpha-synuclein deposition in the brains of patients with Parkinson’s disease (PD) or Multiple System Atrophy (MSA) compared to age-matched healthy controls (AMHC)
Protocol code: MODAG-005-P1-01
Sponsor: Modag GmbH (Pharmaceutical company). Phase: Human Pharmacology (Phase I)- First administration to humans. Countries: Germany (ongoing, recruiting).
Therapeutic area(s): Not possible to specify; Analytical, Diagnostic and Therapeutic Techniques and Equipment [E] - Diagnosis [E01]; Diseases [C] - Nervous System Diseases [C10]
Gender: Female, Male. Age: 18-64 years, 65+ years. Enrolment: 28.
Status: Ongoing, recruiting. Start date (EU): 2026-06-12. Decision date: 2026-05-04. Results received: No. Last updated: 2026-05-04.

Condition(s): Parkinson Disease, Multiple System Atrophy, Healthy Volunteer

Source: https://euclinicaltrials.eu/ctis-public/view/2023-506965-72-00